EU clinical trial 2025-523619-12-00: A Multi-Center, Phase 1/2, Open-Label, Single and Multiple Ascending Dose Study of CRMA-1001 to Evaluate Safety, Tolerability, Pharmacokinetics, Pharmacodynamics, and Efficacy in Adults with Chronic Hepatitis B
Protocol code: CRMA-1001-101
Sponsor: Nchroma Bio Inc. (Pharmaceutical company). Phase: Phase I and Phase II (Integrated)- First administration to humans. Countries: France (authorised, recruiting).
Therapeutic area(s): Diseases [C] - Virus Diseases [C02]
Gender: Female, Male. Age: 18-64 years. Enrolment: 10.
Status: Authorised, recruiting. Start date (EU): 2026-05-22. Decision date: 2026-02-20. Results received: No. Last updated: 2026-06-16.

Condition(s): Chronic Hepatitis B
Product: CRMA-1001

Primary endpoint: Incidence and severity of TEAEs from baseline to Month 6
Endpoint(s): Incidence and severity of TEAEs after Month 6 until end of study, CRMA-1001 in plasma PK parameters, including but not limited to: Cmax, Tmax, AUC, terminal clearance rate, volume of distribution, Incidence and characterization of ADAs by Month 6, Change in HBsAg; Change in anti-HBs antibody titer; Change in HBV DNA; Change in HBeAg in HBeAg-positive participants; Change in anti-HBe antibody titer in HBeAg positive participants. (All biomarkers will be evaluated as change from baseline to Month 6 and change from baseline to end of study), Proportion of participants able to discontinue NUC therapy by end of study, Incidence of functional cure (HBsAg loss [less than 0.05 IU/mL] and HBV DNA below the LLOQ ≥ 6 months after CRMA-1001 treatment and discontinuation of NUC therapy) by end of study

Source: https://euclinicaltrials.eu/ctis-public/view/2025-523619-12-00